EU clinical trial 2024-517014-15-00: Phase II-III study to assess the efficacy and safety of subcutaneous cluster-immunotherapy in patients suffering from house dust mite allergy
Protocol code: SC-3H2A
Sponsor: ROXALL Medizin GmbH (Pharmaceutical company). Phase: Phase II and Phase III (Integrated). Countries: Spain (ended), Germany (ended).
Therapeutic area(s): Diseases [C] - Immune System Diseases [C20]
Gender: Female, Male. Age: 18-64 years. Enrolment: 60.
Status: Ended. Start date (EU): 2025-05-07. End date (EU): 2026-03-30. End date: 2026-04-15. Decision date: 2025-03-12. Results received: No. Last updated: 2025-07-16.
Decision dates by country: DE: 2025-03-12, ES: 2025-03-12

Condition(s): Moderate-to-severe allergic rhinitis / rhino-conjunctivitis due to house dust mites (HDM) for at least one year according to the "Allergic Rhinitis and its Impact on Asthma" (ARIA, Bousquet et al., 2008) guideline,
Product: CLU-RX-DPT mid dose, CLU-RX-DPT low dose, Placebo preparation for subcutanoues use with appearance, smell, taste and excipients identical to verum, but without the active substance, i. e. allergen extract., CLU-RX-DPT high dose

Primary endpoint: The primary (efficacy) endpoint is defined as the absolute differences in mean CSMS (Combined Symptom and Medication Score) during PMP of each active treatment group compared to placebo treatment group.
Endpoint(s): Absolute and relative differences in mean dSS during PMP., Absolute and relative differences in mean dMS during PMP., Global Rhinoconjunctivitis Discomfort with a 10-point Visual Analogue Scale (VAS)., Change in Rhinoconjunctivitis quality of life questionnaire (RQLQ) between active and placebo treatment groups comparing basal and post-treatment scoring., Well and severe days: A well day is defined as a day without administration of any rescue medication (dMS = 0) and with dSS < 0.5 (range 0-3). A severe day is defined (acc. to Pfaar et al., 2014)) as a day with a single score = 3 in any of the four symptoms. Percentages of well and severe days will be calculated for each subject as the number of well or severe days in the PMP in relation to 56 days comprising the PMP., Symptom-free days are defined as the days with absence of symptoms (dSS = 0) and without administration of any rescue medication (dMS = 0), expressed as percentage of days during PMP., tNPT: To assess the efficacy of each dose of CLU-RX-DPT compared to placebo. Defined as % of patients with an increased dosing step and the change in number of dosing steps needed to provoke a positive response in the tNPT post-treatment compared with pre-treatment in each of the 4 study groups. This is based on the change of the response to nasal provocation with incremental concentrations of an allergen extract of D. pteronyssinus from basline to end of treatment.

Source: https://euclinicaltrials.eu/ctis-public/view/2024-517014-15-00